EU clinical trial 2023-508748-23-00: A Phase 1/2a Randomized, Double-Blind Placebo-controlled Study of Intra-articular Allocetra in Knee Osteoarthritis
Protocol code: ENX-CL-05-001
Sponsor: Enlivex Therapeutics Ltd. (Pharmaceutical company). Phase: Phase I and Phase II (Integrated)- Other. Countries: Denmark (ended).
Therapeutic area(s): Diseases [C] - Musculoskeletal Diseases [C05]
Gender: Female, Male. Age: 18-64 years, 65+ years. Enrolment: 156.
Status: Ended. Start date (EU): 2024-03-26. End date (EU): 2026-03-02. End date: 2026-03-03. Decision date: 2024-03-21. Results received: No. Last updated: 2025-09-08.

Condition(s): Knee osteoarthritis
Product: Matching placebo (vehicle), Allocetra-OTS

Primary endpoint: Number and severity of adverse events (AEs), serious adverse events (SAEs) and treatment disruptions/ discontinuations throughout the study from Day 0 and up to 6 months following the last injection
Endpoint(s): Evaluation of change from baseline in weekly average of knee pain as measured using a NRS, assessed at 3 months and 6 months from last study treatment., Change from baseline in WOMAC total score at 3 months, 6 months, and 12 months from last study treatment administration., Change from baseline in WOMAC pain sub-scores at 3 months, 6 months, and 12 months from last study treatment administration., Change from baseline in WOMAC stiffness and disability sub-scores at 3 months, 6 months, and 12 months from last study treatment administration., Change from baseline in QoL as measured by Euro Quality of Life-5-dimension (EQ-5D) questionnaire at 6 months and at 12 months from last study treatment administration., Use of analgesics by 3 months, 6 months, and 12 months from last study treatment administration.

Source: https://euclinicaltrials.eu/ctis-public/view/2023-508748-23-00